EU clinical trial 2023-508474-29-00: Long-Term Extension Study (AtDvance) to Evaluate the Safety and Efficacy of GSK1070806 in Participants with Moderate to Severe Atopic Dermatitis.
Protocol code: 220723
Sponsor: Glaxosmithkline Research & Development Limited (Pharmaceutical company). Phase: Therapeutic exploratory (Phase II). Countries: Czechia (ended), Poland (ended), Germany (ended), Italy (ended), Bulgaria (ended), France (ended), Spain (ended), Greece (ended).
Therapeutic area(s): Diseases [C] - Immune System Diseases [C20]
Gender: Female, Male. Age: 18-64 years, 65+ years. Enrolment: 66.
Status: Ended. Start date (EU): 2024-10-30. End date (EU): 2025-04-08. End date: 2025-07-29. Decision date: 2024-07-15. Results received: Yes. Last updated: 2025-02-20.
Decision dates by country: BG: 2024-07-16, CZ: 2024-07-15, FR: 2024-09-13, DE: 2024-07-15, GR: 2024-10-01, IT: 2024-07-16, ES: 2024-07-15, PL: 2024-07-15

Condition(s): Dermatitis, Atopic
Product: Locally Sourced 0.9% Sodium Chloride

Primary endpoint: "Incidence of: • Adverse events (AEs) and discontinuation from study treatment due to AEs. • Serious adverse events (SAEs) and adverse events of special interest (AESI).
Endpoint(s): Achieving a response (for binary endpoints) at Weeks 16, 32, 48 and every 48 weeks thereafter: • IGA score of 0 or 1 • EASI Reduction of ≥75% from Baseline* • PP-NRS Reduction of ≥4 points, Achieving a maintained response (for binary endpoints) for at least 16/32/48 and every 48 weeks thereafter after first response in: • IGA score of 0 or 1 • EASI Reduction of ≥75% from Baseline* PCFB in the EASI (continuous endpoint) at weeks 16, 32, 48 and every 48 weeks thereafter.

Source: https://euclinicaltrials.eu/ctis-public/view/2023-508474-29-00